EU clinical trial 2025-523157-34-00: A Phase 3 randomized, double-blind, placebo-controlled, parallel group, multicenter study with open-label extension to evaluate the efficacy and safety of fenfluramine hydrochloride in study participants with Rett syndrome
Protocol code: EP0247
Sponsor: UCB Biosciences Inc. (Laboratory/Research/Testing facility). Phase: Therapeutic confirmatory (Phase III). Countries: Spain (ongoing, recruiting), Poland (authorised, recruitment pending), France (authorised, recruitment pending), Hungary (ongoing, recruiting), Belgium (authorised, recruitment pending), Italy (authorised, recruitment pending), Germany (authorised, recruitment pending).
Therapeutic area(s): Diseases [C] - Congenital, Hereditary, and Neonatal Diseases and Abnormalities [C16]
Gender: Female, Male. Age: 0-17 years, 18-64 years. Enrolment: 82.
Start date (EU): 2026-07-14. Decision date: 2026-04-15. Results received: No. Last updated: 2026-04-30.
Decision dates by country: PL: 2026-04-23, ES: 2026-04-27, BE: 2026-04-15, FR: 2026-04-17, DE: 2026-04-30, IT: 2026-04-30, HU: 2026-04-27

Condition(s): Rett syndrome
Product: Fintepla 2.2 mg/ml oral solution, Placebo matching < UCB PRODUCT (ZX008, fenfluramine hydrochloride oral solution) > and without active substance

Primary endpoint: Change from Baseline to Week 14 in Rett Syndrome Behaviour Questionnaire (RSBQ) Total Score, Clinical Global Impression of Change (CGIC) Score at Week 14
Endpoint(s): Change from Baseline to Week 14 in Patient-Reported Outcomes Measurement Information System-Sleep Disturbance (PROMIS-SD) score, Change from Baseline to Week 14 in Observer-Reported Communication Ability (ORCA) score, Caregiver Global Impression of Change – Seizure (CaGIC-Seizure) score at Week 14, Incidence of Treatment-emergent adverse event (TEAEs), Incidence of serious TEAEs, Incidence of TEAEs leading to discontinuation, Incidence of related TEAEs, Change from Baseline in QT interval corrected using Fridericia’s formula (QTcF) interval on 12-lead ECG at Week 14, Treatment-emergent Doppler Echocardiogram (ECHO) results meeting the Food and Drug Administration (FDA) case definition of drug-associated valvular heart disease (VHD), Treatment-emergent Doppler ECHO results meeting the FDA case definition of pulmonary arterial hypertension (PAH) >35mmHg

Source: https://euclinicaltrials.eu/ctis-public/view/2025-523157-34-00